EU clinical trial 2024-514738-18-00: Pragmatic, randomized, multicentric, double-blind, controlled clinicial trial on the treatment of acute gout attacks with prednisolone versus colchicine in primary care (COPAGO)
Protocol code: 202102COPAGO
Sponsor: Universitaetsmedizin Greifswald KöR (Hospital/Clinic/Other health care facility). Phase: Therapeutic use (Phase IV). Countries: Germany (ended).
Therapeutic area(s): Diseases [C] - Musculoskeletal Diseases [C05]
Gender: Female, Male. Age: 18-64 years, 65+ years. Enrolment: 314.
Status: Ended. Start date (EU): 2023-01-12. End date (EU): 2026-02-28. Decision date: 2024-09-20. Results received: No. Last updated: 2025-07-18.

Condition(s): gout, acute gout attack
Product: Placebo Colchicin, PREDNISOLONE, COLCHICINE, Placebo Prednisolon

Primary endpoint: Most severe pain in the last 24 hours
Endpoint(s): average response to treatment from day 1 - 6 of follow-up, Swelling and tenderness of the joint, Physical function on day 6 compared to baseline, Overall assessment of the success of treatment by patients, Most severe pain in the last 24 hours, Frequency of use of additional pain medication per treatment group, Frequency of use of non-drug pain therapies in the treatment groups

Source: https://euclinicaltrials.eu/ctis-public/view/2024-514738-18-00